EU clinical trial 2024-516738-36-00: INTERACT MESO: Intraperitoneal Paclitaxel for Patients with Primary Malignant Peritoneal Mesothelioma – a Phase I/II Dose Escalation and Safety Study
Protocol code: 2021-003637-11
Sponsor: Erasmus Universitair Medisch Centrum Rotterdam (Erasmus MC) (Hospital/Clinic/Other health care facility). Phase: Human Pharmacology (Phase I)- Other. Countries: Netherlands (ended).
Therapeutic area(s): Diseases [C] - Neoplasms [C04]; Analytical, Diagnostic and Therapeutic Techniques and Equipment [E] - Therapeutics [E02]
Gender: Female, Male. Age: 18-64 years, 65+ years. Enrolment: 21.
Status: Ended. End date (EU): 2025-08-26. Decision date: 2024-10-08. Results received: No. Last updated: 2024-10-08.

Condition(s): Patients with malignant peritoneal mesothelioma

Source: https://euclinicaltrials.eu/ctis-public/view/2024-516738-36-00